EU clinical trial 2023-504199-19-00: An open-label, phase I/II study of T3P-Y058-739, a genetically-modified strain of the bacterium Yersinia enterocolitica, in patients with advanced solid tumours
Protocol code: T3P1001
Sponsor: T3 Pharmaceuticals AG (Pharmaceutical company). Phase: Phase I and Phase II (Integrated)- First administration to humans. Countries: Spain (ongoing, recruiting).
Therapeutic area(s): Diseases [C] - Neoplasms [C04]
Gender: Female, Male. Age: 18-64 years, 65+ years. Enrolment: 40.
Status: Ongoing, recruiting. Start date (EU): 2024-06-26. Decision date: 2023-11-06. Results received: No. Last updated: 2026-03-16.

Condition(s): Solid Tumours

Source: https://euclinicaltrials.eu/ctis-public/view/2023-504199-19-00